EU clinical trial 2024-516596-32-00: TRANSPGx: A multicentre, controlled, randomised and single-blind, adaptive phase IV protocol to evaluate effectiveness and cost-effectiveness of pre-emptive genotyping strategy to optimise tacrolimus dosage in a pretransplant chronic kidney disease population cohort
Protocol code: TRANSPGx
Sponsor: Fundacion Para La Investigacion Biomedica Del Hospital Universitario La Paz (Patient organisation/association). Phase: Therapeutic use (Phase IV). Countries: Spain (ongoing, recruitment ended).
Therapeutic area(s): Not possible to specify
Gender: Female, Male. Age: 0-17 years, 18-64 years, 65+ years. Enrolment: 114.
Status: Ongoing, recruitment ended. Start date (EU): 2025-03-31. Decision date: 2025-01-17. Results received: No. Last updated: 2026-04-24.

Condition(s): Kidney transplant
Product: Prograf 0,5 mg Cápsulas duras, Envarsus 0.75 mg prolonged-release tablets, Advagraf 0.5 mg prolonged-release hard capsules, Tacrolimus STADA 0,5 mg cápsulas duras EFG, Adoport 0,5 mg cápsulas duras EFG, Modigraf 0.2 mg oral granules, suspension, Conferoport 0,5 mg cápsulas duras de liberación prolongada EFG

Primary endpoint: Tacrolimus concentrations levels at day 4 (+/-1d) will be the effectiveness surrogate outcome. It will be considered therapeutic range levels between 7-10 ng/ml.
Endpoint(s): Ratio that divides the differences in costs between both treatments by the difference in effectiveness between both treatments., Number and percentage of patients achieving tacrolimus target plasma concentrations., Number and percentage of patients with transplant rejection. Transplant rejection will be considered if there is histological confirmation and/or the patient initiates any type of therapy aimed at treating rejection (e.g. corticosteroids)., Rate of adverse events associated to treatment., Healthcare expenditure related to predefined events of interest: Any costs made as a result of an adverse event., Incidence of discontinuation or treatment modification due to lack of effective related to the drug of inclusion., Identification of new actionable genes/relevant polymorphisms within the predefined population subsets., Novel prognostic and predictive genetic biomarkers of tacrolimus safety and effectiveness will be assessed trough techniques only available at Nation Centre of Oncological Investigations (CNIO) and genome-wide association studies when applicable.

Source: https://euclinicaltrials.eu/ctis-public/view/2024-516596-32-00